EU clinical trial 2023-505435-12-00: A Randomized, Double-Blind, Multicenter, Active-Controlled, Parallel-Group Study to Evaluate the Efficacy and Safety of Fluticasone Propionate/Albuterol Sulfate Fixed--Dose Combination on Severe Asthma Exacerbations in Patients with Asthma
Protocol code: FpA-AS-30094
Sponsor: Teva Branded Pharmaceutical Products R&D LLC (Pharmaceutical company). Phase: Therapeutic confirmatory (Phase III). Countries: Poland (ongoing, recruitment ended), Czechia (ongoing, recruitment ended), Bulgaria (ongoing, recruitment ended), Latvia (ongoing, recruitment ended), Germany (ongoing, recruitment ended), Slovakia (ongoing, recruitment ended), Hungary (ongoing, recruitment ended), Spain (ongoing, recruitment ended), Italy (ended), Romania (ongoing, recruitment ended), Denmark (ongoing, recruitment ended), Greece (ongoing, recruitment ended).
Therapeutic area(s): Diseases [C] - Respiratory Tract Diseases [C08]
Gender: Female, Male. Age: 0-17 years, 18-64 years, 65+ years. Enrolment: 1000.
Start date (EU): 2024-06-04. Decision date: 2024-03-19. Results received: No. Last updated: 2026-05-26.
Decision dates by country: BG: 2024-04-01, PL: 2024-03-25, CZ: 2024-03-28, SK: 2024-03-19, RO: 2024-09-23, HU: 2024-03-26, IT: 2024-09-13, GR: 2024-09-12, LV: 2024-03-27, ES: 2024-03-22, DE: 2024-04-16, DK: 2024-07-16

Condition(s): Asthma
Product: Fluticasone propionate,Salbutamol sulfate, ProAir® RespiClick®, ProAir® Digihaler®, Fluticasone propionate,Salbutamol sulfate

Primary endpoint: Time to first severe CAE with HD Fp/ABS eMDPI.
Endpoint(s): The key efficacy endpoints: - annualized severe CAE rate '- total annualized SCS exposure over the treatment period, - Asthma Control Questionnaire-5 (ACQ-5) response at week 24, defined as achieving a decrease in score from baseline value of at least 0.5, - Asthma Quality of Life Questionnaire + 12 (AQLQ+12) response at week 24, defined as achieving an increase from baseline of at least 0.5, Safety/Tolerability endpoints: '- occurrence of adverse events during the study '- occurrence of serious adverse events during the study '- study withdrawal due to treatment-emergent adverse events, - Time to first severe CAE with LD Fp/ABS eMDPI

Source: https://euclinicaltrials.eu/ctis-public/view/2023-505435-12-00